EU clinical trial 2024-515411-21-00: Repurposing mirtazapine in Rett syndrome: a multicentric open label Phase II study (MirtaRett Study).
Protocol code: MirtaRett
Sponsor: University Of Trieste (Educational Institution). Phase: Therapeutic exploratory (Phase II). Countries: Italy (ongoing, recruiting).
Therapeutic area(s): Diseases [C] - Nervous System Diseases [C10]
Gender: Female. Age: 0-17 years, 18-64 years. Enrolment: 54.
Status: Ongoing, recruiting. Start date (EU): 2025-06-18. Decision date: 2025-02-14. Results received: No. Last updated: 2026-07-29.

Condition(s): Rett Syndrome (RTT)
Product: Mirtapil® 15 mg/ml πόσιμο διάλυμα

Primary endpoint: The rating scale used is the Motor-Behavior Assessment Scale (MBAS). The drug will be considered effective if the treatment decreases the Motor-Behavior Assessment Scale (MBAS) score (maximum score=68) by at least 8.5 points (12.5%) compared to baseline.
Endpoint(s): The drug will be considered effective if the treatment reduces the overall Anxiety, Depression, and Mood Scale (ADAMS) score (maximum score=84) by at least 10.6 points (12.5%) and reduces the overall Rett Syndrome Behaviour Questionnaire (RSBQ) score by at least 11.25 points (12.5%), The drug will be considered effective if the treatment improves the measurements obtained from the medical devices for remote sensing (Youcare Smart T-shirt and the Actigraphy), and the Sleep disturbances scale for children (SDSC) scores by at least 20% compared to the initial value, The drug will be considered effective if the Purposeful Hand Function scale (PHF) score increases at least 2 points above the baseline score., The drug will be considered effective if the Clinical Global Impression of Change scale (CGI-C) has a score decrease at least 1 point, The drug will be considered effective if the Rett Syndrome Severity Scale (RCSS) scores decrease at least 3%, i.e. by 2 points, The assessment will be performed through measurements of thoracic and abdominal respiratory movements, airflow, arterial oxyhaemoglobin saturation (HbSaO2), heart rate and posture, The rating scale used will be the Parenting Stress Index (PSI-SF). An improvement in parental stress will be considered as such, if the Parenting Stress Index (PSI-SF) shows a reduction of at least 20%, The effectiveness of the drug will be assessed by considering a 20% increase from baseline in serum levels of the biomarkers BDNF, GDNF and PDGF

Source: https://euclinicaltrials.eu/ctis-public/view/2024-515411-21-00